EU clinical trial 2023-509135-17-00: Intraperitoneal Aerosolized Nanoliposomal Irinotecan (Nal-IRI) in Peritoneal Carcinomatosis from Gastrointestinal cancer: a phase I study.
Protocol code: PIPAC Nal-IRI
Sponsor: Universitair Ziekenhuis Gent (Hospital/Clinic/Other health care facility). Phase: Human Pharmacology (Phase I)- Other. Countries: Belgium (ongoing, recruitment ended).
Therapeutic area(s): Diseases [C] - Neoplasms [C04]
Gender: Female, Male. Age: 18-64 years, 65+ years. Enrolment: 45.
Status: Ongoing, recruitment ended. Start date (EU): 2022-11-18. Decision date: 2023-12-13. Results received: No. Last updated: 2025-06-13.

Condition(s): Patients with advanced, irresectable peritoneal metastases (PM) originating from gastrointestinal (GI) cancer (colorectal, small bowel, appendix, stomach, pancreatic, cholangiocarcinoma)

Source: https://euclinicaltrials.eu/ctis-public/view/2023-509135-17-00